EU clinical trial 2025-522232-13-00: A Phase IIa, Randomised, Double-blind, Placebo-controlled, Multicentre Study to Assess the Efficacy, Safety, and Tolerability of AZD4144 in Participants with Sepsis-associated Acute Kidney Injury (SERENIA)
Protocol code: D9440C00004
Sponsor: AstraZeneca AB (Pharmaceutical company). Phase: Therapeutic exploratory (Phase II). Countries: Germany (ongoing, recruiting), France (ongoing, recruiting), Spain (ongoing, recruiting), Italy (ended), Belgium (ongoing, recruiting), Czechia (ongoing, recruiting), Greece (ongoing, recruiting), Denmark (ongoing, recruiting), Hungary (authorised, recruitment pending).
Therapeutic area(s): Not possible to specify
Gender: Female, Male. Age: 18-64 years, 65+ years. Enrolment: 66.
Start date (EU): 2026-03-06. Decision date: 2026-01-14. Results received: No. Last updated: 2026-07-08.
Decision dates by country: IT: 2026-01-16, DE: 2026-01-15, HU: 2026-01-15, FR: 2026-01-19, CZ: 2026-02-03, BE: 2026-01-19, GR: 2026-01-14, DK: 2026-02-03, ES: 2026-01-19

Condition(s): Sepsis-associated acute kidney injury (AKI)
Product: Placebo for AZD4144, AZD4144

Primary endpoint: Area Under the Curve (AUC) of 24-hour Creatinine Clearance (CrCl)
Endpoint(s): Days alive and free of KRT, Days alive and free of modified KDIGO AKI Stage 2 or 3, AUC: Serum creatinine, Serum cystatin C, mGFR, Cmax/Cbaseline: Serum creatinine, Serum cystatin C, AUC: Plasma and urine IL-18, Plasma and urine IL-6, Plasma concentrations of AZD4144, Occurrence of any of the following MAKE30 components: (a) Decrease from pre-AKI reference eGFR of ≥ 25% (b) Initiation of KRT at any time (c) Death from any cause, Days alive and free of mechanical ventilation, Days alive and outside of the ICU, Rehospitalisation, Days alive and free of hospitalisation, Days alive and free of vasopressor and/or inotrope use, AUC mSOFA score

Source: https://euclinicaltrials.eu/ctis-public/view/2025-522232-13-00